EU clinical trial 2022-502782-14-00: A Phase 3, Randomized, Double-Blind, Placebo-Controlled Study to Evaluate the Efficacy and Safety of MK-0616 in Adults With Heterozygous Familial Hypercholesterolemia
Protocol code: MK-0616-017
Sponsor: Merck Sharp & Dohme LLC (Pharmaceutical company). Phase: Therapeutic confirmatory (Phase III). Countries: Finland (ended), Norway (ended), Spain (ended), Netherlands (ended), Czechia (ended), Hungary (ended).
Therapeutic area(s): Diseases [C] - Cardiovascular Diseases [C14]
Gender: Female, Male. Age: 18-64 years, 65+ years. Enrolment: 123.
Status: Ended. Start date (EU): 2023-09-28. End date (EU): 2025-04-02. End date: 2025-04-07. Decision date: 2023-09-25. Results received: Yes. Last updated: 2025-02-20.
Decision dates by country: NO: 2023-09-25, ES: 2023-09-27, FI: 2023-09-26, NL: 2023-09-28, HU: 2023-10-02, CZ: 2023-09-26

Condition(s): Heterozygous Familial Hypercholesterolemia (HeFH)
Product: Placebo to MK-0616 - Tablet, MK-0616

Primary endpoint: Mean percent change from baseline in low-density lipoprotein cholesterol (LDL-C) at Week 24, Number of participants with one or more adverse events (AEs), Number of participants who discontinue study drug due to an AE
Endpoint(s): Mean percent change from baseline in LDL-C at Week 52, Mean percent change from baseline in non-high-density lipoprotein cholesterol (HDL-C) at Week 24, Mean percent change from baseline in apolipoprotein B (ApoB) at Week 24, Percent change from baseline in lipoprotein(a) (Lp[a]) at Week 24, Percentage of participants with LDL-C <70 mg/dL and ≥50% reduction from baseline at Week 24, Percentage of participants with LDL-C <55 mg/dL and ≥50% reduction from baseline at Week 24

Source: https://euclinicaltrials.eu/ctis-public/view/2022-502782-14-00